EU clinical trial 2024-515301-26-00: An open label, single-arm, phase 2 study of neoadjuvant sacituzumab govitecan, before radical cystectomy, for patients with muscle-invasive bladder cancer who cannot receive or refuse cisplatin-based chemotherapy
Protocol code: SURE-01
Sponsor: Ospedale San Raffaele S.r.l. (Hospital/Clinic/Other health care facility). Phase: Therapeutic exploratory (Phase II). Countries: Italy (ended).
Therapeutic area(s): Diseases [C] - Neoplasms [C04]
Gender: Female, Male. Age: 18-64 years, 65+ years. Enrolment: 56.
Status: Ended. Start date (EU): 2022-03-23. End date (EU): 2025-09-24. Decision date: 2024-10-14. Results received: No. Last updated: 2026-01-08.
Decision dates by country: IT: 2025-01-27

Condition(s): Muscle-invasive bladder cancer
Product: Trodelvy 200 mg powder for concentrate for solution for infusion

Primary endpoint: Number of complete pathological responses, defined as the absence of viable tumor cells on the histological examination of the cystectomy. Evidence of carcinoma in situ or non-muscle infiltrating disease does not define a complete pathological response.
Endpoint(s): Evaluation of safety and tolerability of the treatment: Number of patients who experienced adverse events. Type, frequency, severity and relationship to the treatment of the adverse events, evaluated according the Common Toxicity Criteria for adverse events (CTCAE) v 5.0. Progression free survival Overall survival

Source: https://euclinicaltrials.eu/ctis-public/view/2024-515301-26-00